EU clinical trial 2023-508381-16-00: A 52-Week, Open-Label Evaluation of the Long-term Efficacy and Safety of Single and Repeated Treatments with Methylone for the Treatment of PTSD IMPACT-EXT (Investigation of Methylone for Post-Traumatic Stress Disorder [PTSD])
Protocol code: TSND201-PTSD-203
Sponsor: Transcend Therapeutics Inc. (Pharmaceutical company). Phase: Therapeutic exploratory (Phase II). Countries: Ireland (ended).
Therapeutic area(s): Psychiatry and Psychology [F] - Mental Disorders [F03]
Gender: Female, Male. Age: 18-64 years, 65+ years. Enrolment: 20.
Status: Ended. Start date (EU): 2024-06-13. End date (EU): 2025-08-12. End date: 2025-10-06. Decision date: 2024-04-05. Results received: Yes. Last updated: 2024-12-16.

Condition(s): Post-Traumatic Stress Disorder
Product: Methylone - 50 mg - capsule

Primary endpoint: Clinician-Administered PTSD Scale for DSM-5 (CAPS-5) (total severity score; primary efficacy outcome measure), PTSD Checklist for DSM-5 (PCL-5), Montgomery-Åsberg Depression Rating Scale (MADRS), Sheehan Disability Scale (SDS), Clinical Global Impression of Improvement (CGI-I), Clinical Global Impression of Severity (CGI-S), Patient Global Impression of Change (PGI-C), Patient Global Impression of Severity (PGI-S), Quick Inventory Depressive Symptoms (QIDS), Pittsburgh Sleep Quality Index (PSQI), Warwick-Edinburgh Mental Wellbeing Scale (WEMWBS), Post-Traumatic Growth Inventory (PTGI)
Endpoint(s): Columbia-Suicide Severity Rating Scale (C-SSRS), Serious Adverse Events (SAE) and Adverse Events of Special Interest (AESI), Adverse events (serious and non-serious) during Methylone treatment, Vital signs (blood pressure [BP], heart rate, temperature) during Methylone treatment, Clinical labs (chemistry, haematology, urinalysis) during Methylone treatment, Electrocardiogram (ECG) during Methylone treatment

Source: https://euclinicaltrials.eu/ctis-public/view/2023-508381-16-00